EU clinical trial 2023-510016-39-00: Ketamine Low dOse Evaluation on morphine consumption in traumatic patient
Protocol code: RCAPHM19_0374
Sponsor: Assistance Publique Hopitaux De Marseille (Hospital/Clinic/Other health care facility). Phase: Therapeutic confirmatory (Phase III). Countries: France (ended).
Therapeutic area(s): Analytical, Diagnostic and Therapeutic Techniques and Equipment [E] - Anesthesia and Analgesia [E03]
Gender: Female, Male. Age: 18-64 years, 65+ years. Enrolment: 140.
Status: Ended. Start date (EU): 2022-08-05. End date (EU): 2025-10-09. Decision date: 2024-07-31. Results received: No. Last updated: 2025-05-28.

Condition(s): Traumatism
Product: placebo ketamine inj prep, KETAMINE RENAUDIN 10 mg/ml, solution injectable

Primary endpoint: Total dose of sufentanil administered is deferred to 48 hours of management.
Endpoint(s): Cumulative dose of opioids administered during the first 5 days of care., Average VAS during the first 5 days of treatment., Rate of delirium according to the CAM-ICU scale, Rate of occurrence and quantification of nausea and/or vomiting using a semi-quantitative method (absent, mild, moderate, severe) previously described, Rate of occurrence of acute urinary retention/urinary globe, Rate of occurrence of neurological distress (seizure) or hemodynamic distress (rhythm disturbance / cardiac arrest / hypertensive crisis defined as systolic blood pressure > 180mmHg without associated pain factor) or respiratory distress (orotracheal intubation for respiratory distress, use of non-invasive ventilation or high-flow oxygen therapy (>10L) for respiratory distress), Rate of occurrence of a hepatic complication defined as an increase in liver enzymes (ALAT) of more than 3 times the high normal value, or an increase of more than 100% in initial bilirubin values, or a decrease in factor V below 50% in the absence of an explanation linked to the management of the trauma or hemorrhage., Length of stay in intensive care unit and total length of hospitalization defined as the number of days between the date of admission and discharge from the intensive care unit and hospitalization., Amount of analgesic treatment taken daily, overall quality of life, occurrence and quantification and location of potential chronic pain according to the SF-MPQ-2 and SPRINT and SF-36 questionnaires

Source: https://euclinicaltrials.eu/ctis-public/view/2023-510016-39-00